EU clinical trial 2023-504704-28-00: Transdermal estradiol and exercise in mitigating adverse effects of androgen deprivation therapy for prostate cancer radiation therapy (ESTRACISE)
Protocol code: ESTRACISE
Sponsor: Central Finland Hospital District Central Finland Hospital Nova (Hospital/Clinic/Other health care facility). Phase: Therapeutic exploratory (Phase II). Countries: Finland (ongoing, recruiting).
Therapeutic area(s): Diseases [C] - Male Urogenital Diseases [C12]
Gender: Male. Age: 18-64 years, 65+ years. Enrolment: 310.
Status: Ongoing, recruiting. Start date (EU): 2024-09-01. Decision date: 2023-08-21. Results received: No. Last updated: 2025-12-17.

Condition(s): Prostate cancer
Product: Estrogel 0,6 mg/g -geeli, Estrogel® 0,6 mg/g-gel, doseringspump, Orgovyx 120 mg film-coated tablets, Enanton Depot Dual 11,25 mg injektiokuiva-aine ja liuotin suspensiota varten, esitäytetty ruisku, LEUPRORELIN, Estrogel 0,6 mg/g -geeli, Leuprorelin Sandoz 5 mg implantaatti, esitäytetty ruisku

Primary endpoint: Primary endpoint will be the efficacy of transdermal estradiol in mitigating the sexual symptoms of ADT
Endpoint(s): Occurrence of ADT-induced adverse effects during ADT in different study groups, Tolerability and safety of transdermal E2 during the one-year ADT adjuvant treatment period, Impact of transdermal E2 with or without 6-month resistance exercise on the muscle strength, functional capacity, body composition, lean-body muscle mass, and systematic biomarkers (g.e., blood biomarkers of and inflammatory health and muscle biomarkers), Safety and tolerability of 6-month physical exercise combined with or without transdermal E2 during ADT, Quality of life and perceived fatigue during ADT in different study groups

Source: https://euclinicaltrials.eu/ctis-public/view/2023-504704-28-00